EU clinical trial 2023-509139-16-00: A Phase 3, Randomized, Double-blind, Placebo-controlled Study to Evaluate Sotatercept When Added to Background Pulmonary Arterial Hypertension (PAH) Therapy in Newly Diagnosed Intermediate- and High-risk PAH Patients
Protocol code: A011-13
Sponsor: Acceleron Pharma Inc. (Pharmaceutical company). Phase: Therapeutic confirmatory (Phase III). Countries: Spain (ended), Poland (ended), France (ended), Belgium (ended), Portugal (ended), Czechia (ended), Netherlands (ended), Germany (ended), Croatia (ended), Denmark (ended), Italy (ended), Austria (ended), Greece (ended).
Therapeutic area(s): Diseases [C] - Cardiovascular Diseases [C14]
Gender: Female, Male. Age: 18-64 years, 65+ years. Enrolment: 253.
Status: Ended. Start date (EU): 2022-05-13. End date (EU): 2025-04-03. Decision date: 2024-09-24. Results received: Yes. Last updated: 2025-05-20.
Decision dates by country: PT: 2024-09-24, BE: 2024-09-24, IT: 2024-10-01, PL: 2024-09-25, DK: 2024-09-27, NL: 2024-09-24, ES: 2024-09-25, DE: 2024-09-26, AT: 2024-09-29, GR: 2024-10-11, CZ: 2024-09-25, HR: 2024-09-26, FR: 2024-09-27

Condition(s): Therapeutic confirmatory (phase III)
Product: sotatercept, PL1 - Powder for injection

Primary endpoint: The primary efficacy endpoint is TTCW.The events that will comprise this endpoint include the following:All-cause death,Non-planned PAH-related hospitalization of ≥24 hours in duration,Atrial septostomy,Lung transplant. Deterioration in performance in exercise testing due to PAH,and at least 1 of the following:Worsening of WHO FC from baseline,Signs/symptoms of increased right heart failure.Addition of a background PAH therapy or change in the background PAH therapy delivery route to parenteral, Cont. Translation- German (AT), Cont. Translation- Croatian, Cont. Translation- French, Cont. Translation- Dutch, Cont. Translation- Portuguese
Endpoint(s): Multicomponent improvement endpoint: Measure of participants achieving improvement in 6MWD, NT-proBNP, and WHO FC at Week 24. achieving low-risk category in REVEAL Lite 2 risk score; using simplified French Risk score calculator; change in NT-proBNP levels; maintaining or improving WHO FC at 24 weeks; change in 6MWD; and changes in the Physical Impacts, Cardiopulmonary Symptoms, and Cognitive/Emotional Impacts domain scores of PAH-SYMPACT® at Week 24 versus baseline., Cont. Translation- German (AT), Cont. Translation- Croatian, Cont. Translation- France, Cont. Translation- Dutch, Cont. Translation- Portuguese

Source: https://euclinicaltrials.eu/ctis-public/view/2023-509139-16-00